EU clinical trial 2023-507316-12-00: Open label, single-center, four-part registration pharmacokinetic study: Part I: Pilot 2-way cross-over randomized, comparative pharmacokinetic study of a new gastro-resistant 20 mg pitolisant hydrochloride formulation versus the reference formulation, after a single 20 mg oral administration in twelve healthy subjects, in order to evaluate the adequate sample size to demonstrate the bioequivalence. Part II: One sequence cross-over, drug-drug interaction pharmacokinetic study between a proton pump inhibitor (PPI) (pantoprazole 40 mg) and a new gastro-resistant 20 mg pitolisant hydrochloride formulation in eighteen healthy subjects. Part III: Pivotal 4-way replicate design cross-over randomized, bioequivalence study of a new gastro-resistant 20 mg pitolisant hydrochloride formulation versus the reference formulation, after single oral 20 mg administration in healthy subjects. Part IV: 2-way cross-over randomized, food effect study of a new gastro-resistant 20 mg pitolisant hydrochloride formulation administered under fasting conditions and after a standard FDA High Fat Breakfast in eighteen healthy subjects.
Protocol code: P22-12
Sponsor: Bioprojet Pharma (Pharmaceutical company). Phase: Human Pharmacology (Phase I)- Other. Countries: Belgium (ended).
Therapeutic area(s): Diseases [C] - Nervous System Diseases [C10]
Gender: Female, Male. Age: 18-64 years. Enrolment: 104.
Status: Ended. Start date (EU): 2023-10-20. End date (EU): 2025-10-06. Decision date: 2023-10-10. Results received: No. Last updated: 2025-06-03.

Condition(s): Narcolepsy with cataplexy, Narcolepsy

Source: https://euclinicaltrials.eu/ctis-public/view/2023-507316-12-00